EU clinical trial 2023-509196-16-00: A Multicentre, Interventional, Post-marketing, Randomised, Double-blind, Crossover Study to Evaluate the Clinical Safety and Efficacy of AbobotulinumtoxinA (Dysport®) in Comparison with OnabotulinumtoxinA (Botox®) when Treating Adults with Upper Limb Spasticity
Protocol code: CLIN-52120-452
Sponsor: Ipsen Pharma (Pharmaceutical company). Phase: Therapeutic use (Phase IV). Countries: France (ended).
Therapeutic area(s): Diseases [C] - Nervous System Diseases [C10]
Gender: Female, Male. Age: 18-64 years, 65+ years. Enrolment: 50.
Status: Ended. Start date (EU): 2021-11-19. End date (EU): 2025-03-04. End date: 2025-08-26. Decision date: 2024-03-21. Results received: Yes. Last updated: 2026-01-12.

Condition(s): Upper limb spasticity (ULS) of any aetiology (in US and France) or post- stroke ULS (in Canada)
Product: BOTOX 200 UNITÉS ALLERGAN, poudre pour solution injectable, DYSPORT 500 UNITES SPEYWOOD, poudre pour solution injectable

Primary endpoint: Rate of TEAEs from injection to 12 weeks
Endpoint(s): Rate of ADRs, SAEs and AESIs from injection to 12 weeks, Duration of response based on retreatment criteria, Muscle tone assessed by the MAS for finger, wrist and elbow flexors at 1, 4, 10, 12 ± 16, 20, 24 weeks based on PTMG and MAS total score, Perceived function and pain assessed by the DAS at 1, 4, 10, 12 ± 16, 20, 24 weeks based on PTT and DAS total score, PGA of treatment response at 1, 4, 10, 12 ± 16, 20, 24 weeks, QoL, using the SF-12 perceived health score and SQoL-6D at 4 weeks, 12 weeks and at end of each cycle

Source: https://euclinicaltrials.eu/ctis-public/view/2023-509196-16-00